EU clinical trial 2024-514152-32-00: A Study to Test How Safe, Effective and How the Body Responds to the Combination of Mosunetuzumab and Pirtobrutinib Together to Treat Patients with Relapsed or Refractory Chronic Lymphocytic Leukemia and Small Lymphocytic Lymphoma
Protocol code: BO45287
Sponsor: F. Hoffmann-La Roche AG (Pharmaceutical company). Phase: Human Pharmacology (Phase I)- Other. Countries: France (ongoing, recruiting), Spain (authorised, recruiting), Poland (ongoing, recruiting).
Therapeutic area(s): Diseases [C] - Neoplasms [C04]
Gender: Female, Male. Age: 18-64 years, 65+ years. Enrolment: 22.
Start date (EU): 2025-10-06. Decision date: 2025-09-25. Results received: No. Last updated: 2026-07-13.
Decision dates by country: PL: 2025-09-27, ES: 2025-10-02, FR: 2025-11-21

Condition(s): Relapsed or Refractory Chronic Lymphocytic Leukemia (R/R CLL) and Small Lymphocytic Lymphoma (SLL)

Source: https://euclinicaltrials.eu/ctis-public/view/2024-514152-32-00